EU clinical trial 2023-504828-25-00: A Phase 1b/2, Open-Label, Safety and Efficacy Study of Epcoritamab (GEN3013; DuoBody®-CD3 X CD20) in Relapsed/Refractory Chronic Lymphocytic Leukemia and Richter's Syndrome
Protocol code: GCT3013-03
Sponsor: Genmab A/S (Pharmaceutical company). Phase: Phase I and Phase II (Integrated)- Other. Countries: Netherlands (ongoing, recruitment ended), Denmark (ongoing, recruitment ended), Belgium (ongoing, recruitment ended), France (ongoing, recruitment ended), Italy (ended), Spain (ongoing, recruitment ended), Czechia (ongoing, recruitment ended), Germany (ended), Poland (ongoing, recruitment ended).
Therapeutic area(s): Diseases [C] - Neoplasms [C04]
Gender: Female, Male. Age: 18-64 years, 65+ years. Enrolment: 125.
Start date (EU): 2020-11-16. Decision date: 2024-05-14. Results received: No. Last updated: 2026-08-05.
Decision dates by country: IT: 2024-05-20, DE: 2024-05-15, FR: 2024-06-11, CZ: 2024-05-15, PL: 2024-05-31, BE: 2024-05-22, NL: 2024-05-15, DK: 2024-05-14, ES: 2024-05-14

Condition(s): Chronic Lymphocytic Leukemia
Product: VENETOCLAX, Epcoritamab, PREDNISOLONE, Jaypirca 50 mg film-coated tablets, CYCLOPHOSPHAMIDE, Jaypirca 100 mg film-coated tablets, RITUXIMAB, Epcoritamab, VINCRISTINE, DOXORUBICIN, LENALIDOMIDE

Primary endpoint: Monotherapy Cohorts (R/R CLL) • Incidence of DLTs • Incidence and severity of AEs and SAEs. • Incidence and severity of CRS, ICANS and TLS, Monotherapy (R/R CLL [Arm 1 and 1A] and RS [Arm 2A]): • ORR, Dose Escalation Venetoclax Combination Therapy (R/R CLL) • Incidence of DLTs • Incidence and severity of AEs, Expansion Venetoclax Combination Therapy in R/R CLL (Arm 3) • ORR as assessed by the IRC, Expansion Lenalidomide Combination Therapy in RS (Arm 2B) and R CHOP Combination Therapy in RS (Arm 2C) • ORR as assessed by the IRC
Endpoint(s): Monotherapy (R/R CLL [Arm 1] and RS [Arm 2A]), Expansion Lenalidomide Combination Therapy in RS (Arm 2B) and R CHOP Combination Therapy in RS (Arm 2C): • DOR • CR rate (both cohorts)/CRi rate (CLL cohort only) • PR/nPR rate • TTR • PFS • OS • TTNT • Incidence and severity of AEs and SAEs. • Incidence and severity of CRS, ICANS, and CTLS • PK parameters • Incidence of overall MRD negativity • Duration of MRD negativity • Incidence of ADAs to epcoritamab, Dose Escalation Venetoclax Combination Therapy (R/R CLL) • ORR • DOR • CR/CRi rate • TTR • PFS • OS • TTNT • PK parameters • Incidence of overall MRD negativity • Duration of MRD negativity • Incidence of ADAs to epcoritamab, Safety Run-in Pirtobrutinib Combination Therapy (R/R CLL – Cohort CP1) • ORR • DOR • CR/CRi rate • TTR • PFS • OS • TTNT • PK parameters • Incidence of overall MRD negativity • Incidence of MRD negativity 3 months after Day 1 of last cycle • Duration of MRD negativity • Incidence of ADAs to epcoritamab, Expansion Pirtobrutinib Combination Therapy in R/R CLL (Arm 4) • ORR • DOR • CR/CRi rate • TTR • PFS • OS • TTNT • Incidence and severity of AEs and SAEs • Incidence and severity of CRS, ICANS, and CTLS • PK parameters • Incidence of overall MRD negativity • Incidence of MRD negativity 3 months after Day 1 of last cycle • Duration of MRD negativity • Incidence of ADAs to epcoritamab

Source: https://euclinicaltrials.eu/ctis-public/view/2023-504828-25-00